EU clinical trial 2025-524774-42-00: The NOVA-NOA Trial A Novel Aromatase Inhibitor, Leflutrozole, for Treatment of Non-Obstructive Azoospermia
Sponsor: Herlev Hospital (Hospital/Clinic/Other health care facility). Phase: Therapeutic exploratory (Phase II). Countries: Denmark (ongoing, recruiting).
Therapeutic area(s): Diseases [C] - Male Urogenital Diseases [C12]
Gender: Male. Age: 18-64 years. Enrolment: 15.
Status: Ongoing, recruiting. Start date (EU): 2026-06-30. Decision date: 2026-04-07. Results received: No. Last updated: 2026-04-07.

Condition(s): Male Infertility

Primary endpoint: The primary endpoint is proportion of patients with spermatozoa in the ejaculate at Week 12-20.
Endpoint(s): Changes in serum reproductive hormones (FSH, LH, Testosterone, Estradiol, Inhibin B, AMH, SHBG), Changes in the concentration of RANKL, OPG, AMH, and Inhibin B in seminal fluid, Change in serum Inhibin B/FSH ratio, Testosterone/LH ratio, Testosterone/Estradiol and AMH/Testosterone ratio, Changes in BMI, Changes in HbA1c, fasting- glucose, c-peptide, insulin and HOMA-IR, Changes in lipids (total cholesterol, LDL, HDL and triglycerides), Changes in hematocrit, Change in circulating markers of bone resorption and formation (PINP and CTX), Change in mineral homeostasis in spot urine (albumin, calcium, magnesium, iron, fer-ritin, phosphate, zinc, bicarbonate, citrate), Change in mineral homeostasis in serum (albumin, calcium, phosphate, magnesium, iron, ferritin, transferrin, hepcidin, zinc), Change in mineral homeostasis in seminal fluid (albumin, calcium, phosphate, magne-sium, iron, ferritin, zinc), Changes in calciotropic hormones (PTH, Klotho and FGF23), Changes in serum vitamin D metabolites (cholecalciferol, 25OHD, 24,25OHD, 1,25OH2D3 and cholecalciferol/25OHD ratio, 25OHD/24,25OHD ratio), Changes in androstenedione, cortisone and DHEAS, Plasma and semen concentrations of leflutrozole in the participant and plasma concen-trations of leflutrozole in the female partner, Change in sperm count, concentration, motility, and morphology when possible.

Source: https://euclinicaltrials.eu/ctis-public/view/2025-524774-42-00